EU clinical trial 2025-520794-39-00: SGLT2 INHIBITION FOR CARDIOVASCULAR ENDPOINT REDUCTION IN HYPERTENSION
Protocol code: 724154
Sponsor: Universitaetsklinikum Schleswig-Holstein AöR (Hospital/Clinic/Other health care facility). Phase: Therapeutic confirmatory (Phase III). Countries: Germany (ongoing, recruiting), Slovenia (ongoing, recruiting), Spain (authorised, recruiting), Austria (ongoing, recruiting), Portugal (authorised, recruitment pending), Italy (authorised, recruitment pending).
Therapeutic area(s): Diseases [C] - Cardiovascular Diseases [C14]
Gender: Female, Male. Age: 18-64 years, 65+ years. Enrolment: 3540.
Start date (EU): 2025-12-10. Decision date: 2025-10-08. Results received: No. Last updated: 2026-05-18.
Decision dates by country: SI: 2026-03-31, ES: 2026-03-31, AT: 2026-05-04, PT: 2026-04-14, IT: 2026-04-30, DE: 2025-10-08

Condition(s): Arterial Hypertension
Product: Dapagliflozin Ascend 10 mg Filmtabletten, Placebo for Dapagliflozin

Primary endpoint: Time until first occurrence of, - non-fatal stroke,, - non-fatal myocardial infarction,, - revascularisation procedures for atherosclerotic disease,, - hospitalisation or emergency department for HF,, - unplanned hospitalisation for new-onset atrial fibrillation (AF), new-onset atrial flutter (AFL) or ventricular arrhythmia,, - sustained decline in the eGFR of at least 50% (estimated by CKD-EPICr 2021 formula), - end-stage kidney disease o defined as eGFR <15 mL/min/1.73m2 or requiring chronic dialysis or renal transplantation,, - death from renal or CV causes
Endpoint(s): Individual components of the primary composite outcome, All-cause mortality, Rate of the decline in the eGFR, estimated by CKD-EPICr 2021 formula at 8 weeks and 48 months, Change in systolic BP at 8 weeks, 12 months and 48 months, Change in diastolic BP at 8 weeks, 12 months and 48 months, Composite of primary endpoint or death from any cause, Development of type 2 diabetes,, Time to coronary revascularization procedure, Improvement in quality of life (respective area-under-the-curve (AUC) of EQ VAS Score and HeartQoL Global Score changes. (Assessment Points: Baseline, 12 months, 24, and 48 months)., Decline of cognition (MoCA Test Score, Assessment Points: Baseline, 12 months, 24, and 48 months), Increase of blood markers of neurodegeneration (Ptau 217, Nfl) (Assessment Points: Baseline, 12 months, 24, and 48 months), Frailty (Assessment Points: Baseline, 12 months, 24, and 48 months)

Source: https://euclinicaltrials.eu/ctis-public/view/2025-520794-39-00